EU clinical trial 2023-506112-40-00: A Phase 3, Multicenter, Randomized, Open Label Study of Venetoclax and Dexamethasone Compared with Pomalidomide and Dexamethasone in Subjects with t(11;14)-Positive Relapsed or Refractory Multiple Myeloma
Protocol code: M13-494
Sponsor: AbbVie Deutschland GmbH & Co. KG (Pharmaceutical company). Phase: Therapeutic confirmatory (Phase III). Countries: Italy (ongoing, recruitment ended), Czechia (ended), Denmark (ongoing, recruitment ended), France (ongoing, recruitment ended), Spain (ended), Germany (ended), Greece (ongoing, recruitment ended).
Therapeutic area(s): Diseases [C] - Neoplasms [C04]
Gender: Female, Male. Age: 18-64 years, 65+ years. Enrolment: 91.
Start date (EU): 2018-09-26. Decision date: 2024-01-10. Results received: No. Last updated: 2026-07-20.
Decision dates by country: CZ: 2024-01-15, IT: 2024-01-12, FR: 2024-01-10, DK: 2024-01-10, ES: 2024-01-11, GR: 2024-02-23, DE: 2024-01-11

Condition(s): R/R Multiple Myeloma
Product: DEXAMETHASONE, Imnovid 3 mg hard capsules, Imnovid 2 mg hard capsules, Imnovid 4 mg hard capsules, Venetoclax, Imnovid 1 mg hard capsules

Primary endpoint: The primary efficacy endpoint is progression-free survival (PFS) per Independent Review Committee (IRC) based on IMWG criteria. PFS is defined as the time in days from subject randomization to the date of the first documented progressive disease (PD) or death due to any cause, whichever occurs first.
Endpoint(s): Overall response rate (ORR) per the independent review committee (IRC), Rate of very good partial response (VGPR) or better per the IRC, Overall survival (OS), Minimal residual disease (MRD) negativity rate, Time to deterioration in disease symptoms as measured by the disease symptom domain of the EORTC QLQ-MY20, Time to deterioration in physical functioning as measured by the physical functioning domain of EORTC QLQ-C30, Other Patient reported outcomes (PROs) assessed using Patient Reported Outcomes Measurement Information System (PROMIS) Fatigue Short Form 7a, Brief Pain Inventory –Short Form [(BPI-SF]), EuroQoL 5 Dimension 5 Level (EQ5D5L) and remaining domains of EORTC QLQ-MY20, and EORTC QLQ-C30 survey instruments, Duration of response (DOR), Time to disease progression (TTP), Time to response (TTR), Pharmacokinetics of venetoclax, Safety

Source: https://euclinicaltrials.eu/ctis-public/view/2023-506112-40-00